EU clinical trial 2024-516292-33-00: Study to Evaluate the PK and Safety of Oral Decitabine and Cedazuridine in Cancer Patients with Hepatic Impairment
Protocol code: ASTX727-18
Sponsor: Taiho Oncology Inc. (Pharmaceutical company). Phase: Human Pharmacology (Phase I)- Other. Countries: Bulgaria (ended), Slovakia (authorised, recruiting), Spain (ongoing, recruiting), Poland (authorised, recruiting), Romania (ongoing, recruiting).
Therapeutic area(s): Diseases [C] - Neoplasms [C04]
Gender: Female, Male. Age: 18-64 years, 65+ years. Enrolment: 50.
Start date (EU): 2021-10-22. Decision date: 2024-08-29. Results received: No. Last updated: 2026-06-03.
Decision dates by country: BG: 2024-09-16, ES: 2024-08-29, PL: 2024-09-30, RO: 2024-10-08, SK: 2024-09-06

Condition(s): Myelodysplastic syndrome (MDS), Solid tumor, Acute myeloid lymphoma (AML)

Source: https://euclinicaltrials.eu/ctis-public/view/2024-516292-33-00